EU clinical trial 2024-512478-86-00: Pharmacologic treatment augmentation in chronic depression “randomized, controlled, double blinded, phase II study”
Protocol code: Ketamin plus CBASP
Sponsor: Universitaetsklinikum Tuebingen AöR (Hospital/Clinic/Other health care facility). Phase: Therapeutic exploratory (Phase II). Countries: Germany (ongoing, recruiting).
Therapeutic area(s): Psychiatry and Psychology [F] - Mental Disorders [F03]
Gender: Female, Male. Age: 18-64 years, 65+ years. Enrolment: 60.
Status: Ongoing, recruiting. Start date (EU): 2023-07-07. Decision date: 2024-04-10. Results received: No. Last updated: 2026-05-26.

Condition(s): Diagnosis of chronic depression
Product: Ketamin Inresa 2 ml 50 mg/ml Injektionslösung; Ketaminhydrochlorid, SODIUM CHLORIDE

Primary endpoint: Depressive symptoms will be assessed by the Montgomery Asberg Depression Rating Scale(MADRS, Schmidtke et al., 1988), a standardized and widely used clinician rating scale. TheMADRS will be conducted by a rater independent of the the treatment team and blind totreatment condition.

Source: https://euclinicaltrials.eu/ctis-public/view/2024-512478-86-00